EU clinical trial 2024-512980-29-00: The PRESTO Trial - Organ preservation with durvalumab-based immunotherapy in combination with chemoradiation as definitive therapy for early stage, cT1 and cT2N0, esophageal adenocarcinoma with indication for radical surgery: A prospective, multicenter study of the FLOT-AIO Gastric Cancer Group
Protocol code: PRESTO
Sponsor: Frankfurter Institut Fuer Klinische Krebsforschung IKF GmbH (Pharmaceutical company). Phase: Therapeutic exploratory (Phase II). Countries: Germany (ongoing, recruitment ended).
Therapeutic area(s): Diseases [C] - Neoplasms [C04]
Gender: Female, Male. Age: 18-64 years, 65+ years. Enrolment: 32.
Status: Ongoing, recruitment ended. Start date (EU): 2023-08-28. Decision date: 2024-08-02. Results received: No. Last updated: 2026-03-17.

Condition(s): T1-T2N0 esophageal adenocarcinoma including gastroesophageal junction (GEJ) with indication for radical surgery
Product: Leucovorin 10 mg/ml Lösung zur Injektion/ Infusion, TAXOTERE 20 mg/1 ml concentrate for solution for infusion, medoxa 5 mg/ml Konzentrat zur Herstellung einer Infusionslösung, IMFINZI 50 mg/mL concentrate for solution for infusion., 5-FU medac 50 mg/ml, Injektionslösung

Primary endpoint: Rate of clinical and pathological complete response rate at time of endoscopic re-evaluation (at the end of the core study treatment) according to Becker criteria and investigator-based RECIST v1.1 assessment as well as endoscopic response criteria similar to the Japanese Gastric Cancer Association Guideline
Endpoint(s): Rate of cCR/pCR at 1, 2 and 3 years after start of treatment (long term follow up), Subgroup analysis of cCR/pCR rate at time of endoscopic re-evaluation and after 1 year according to following characteristics: MSI high, PD-L1 CPS>1 and PD-L1 CPS>5 and especially acc. to CPS ≥10 or <10, Rate of salvage surgery, 90-day as well as 1-year mortality after start of treatment in nonsurgery population and population with salvage surgery, Determination of the sites of tumor relapse, Incidence of adverse events (AEs), serious adverse events (SAEs) and adverse events of special interest (AESIs), Severity of adverse events by CTCAE v5.0 grade, Relationship of adverse events to the durvalumab, chemotherapy and/or radiation, Frequency of clinically significant abnormal laboratory parameters, Assessment of quality of life (QoL) data from patients using EORTC QLQC30 and the esophageal module OES18

Source: https://euclinicaltrials.eu/ctis-public/view/2024-512980-29-00